EU clinical trial 2025-521420-30-00: Dual wavelength fluorescence imaging using fluorescently labelled adalimumab and risankizumab for visualizing drug targeting in Inflammatory Bowel Diseases (VOYAGER)
Protocol code: 21773
Sponsor: Universitair Medisch Centrum Groningen (Hospital/Clinic/Other health care facility). Phase: Phase I and Phase II (Integrated)- Other. Countries: Netherlands (ongoing, recruiting).
Therapeutic area(s): Diseases [C] - Digestive System Diseases [C06]; Diseases [C] - Immune System Diseases [C20]
Gender: Female, Male. Age: 18-64 years, 65+ years. Enrolment: 30.
Status: Ongoing, recruiting. Start date (EU): 2026-05-08. Decision date: 2026-01-06. Results received: No. Last updated: 2026-01-06.

Condition(s): Inflammatory Bowel Disease (IBD)
Product: Skyrizi 600 mg concentrate for solution for infusion, Humira 40 mg solution for injection in pre-filled syringe

Primary endpoint: Visual evaluation and distinction of both tracers during FME (visible signal yes/no), TBR and CNR calculations, mean fluorescence intensities (MFIs) of biopsies, MDSFR/SFF measurements and fluorescence/ light sheet microscopy
Endpoint(s): Analysis of in vivo fluorescence images and quantification of fluorescence signal in real-time by spectroscopy. Semi-quantification of the fluorescence within mucosal biopsies (FFPE) with fluorescence scans and comparison with endoscopic/histologic inflammation score and in vivo results. Look at possible correlation of in vivo and ex vivo measured and quantified fluorescence and endoscopic/histologic response to adalimumab/risankizumab therapy, Quantification of fluorescent signals by dual wavelengths spectroscopy during the endoscopy. Measurements will be correlated with fluorescence intensities visualized using the FME camera and endoscopic/histologic inflammation severity to draw any conclusions about adalimumab/risankizumab distribution into inflamed or non-inflamed tissue. We hypothesize a positive correlation between the fluorescence signal and the tracer dose and between the fluorescence signal and the inflammation scores, 3D ex vivo fluorescence signal analysis on intact biopsies taken in high and low fluorescence areas during the endoscopy to assess the distribution of labeled adalimumab-680LT/risankizumab-800CW. We use SDS-PAGE with protein extract of the biopsies obtained during the endoscopy procedures and the patients' blood samples to prove tracer integrity. We will detect the protein and mRNA expression of TNF and IL23 via Western Blot to determine a correlation between tracer signal and target expression, We will perform fluorescence microcopy on FFPE slides of the biopsies to microscopically visualize the adalimumab-680LT/risankizumab-800CW signal and perform additional immunofluorescence staining (CD68, CD3, CD8, CD20, etc.) for different immune cell types to identify the immune cell type of adalimumab-680LT/risankizumab-800CW positive cells

Source: https://euclinicaltrials.eu/ctis-public/view/2025-521420-30-00